EU clinical trial 2025-524884-18-01: Comparison of iodinated contrast media injection protocols with reduced flow rates and volumes on image quality in diagnostic cerebral angiography for the evaluation of unruptured intracranial aneurysms: towards a standardization of practices (OPIAC)
Protocol code: 9882
Sponsor: Les Hopitaux Universitaires De Strasbourg (Hospital/Clinic/Other health care facility). Phase: Therapeutic confirmatory (Phase III). Countries: France (authorised, recruitment pending).
Therapeutic area(s): Diseases [C] - Nervous System Diseases [C10]
Gender: Female, Male. Age: 18-64 years, 65+ years. Enrolment: 244.
Status: Authorised, recruitment pending. Decision date: 2026-05-22. Results received: No. Last updated: 2026-05-22.

Condition(s): Intracranial aneurysms
Product: Visipaque 270 550 mg/ml (<> 270 mg I/ml) solução injectável

Primary endpoint: Ratio of exploitable 2D and 3D images, assessed by radiographers, obtained with each injection protocol (reduced flow rates/standard volumes; reduced volumes/standard flow rates; reduced flow rates and volumes), compared to the standard/empirical protocol
Endpoint(s): Accordance between radiographers’ assessment and interventional neuroradiologist evaluation regarding images classified as exploitable or non-exploitable, and inter- evaluator reproducibility (between radiographers, between neuroradiologists, and between radiographers and neuroradiologists);, Patient discomfort assessed orally by a radiographer or nurse in the theatre using a simple verbal scale (EVS, Échelle Verbale Simple, score 0-4) at the beginning of procedure (baseline) and after each injection/acquisition; Patient satisfaction assessed using a SAPS questionnaire, and inventory of side effects and their maximum intensity at the end of the examination, Description of the results obtained from a qualitative assessment grid and correlation with the quantitative results; Analysis of the predictive reliability of the grid in relation to images exploitability; Analysis of inter-evaluator reproducibility of the grid, Average ICM cost per protocol, depending on the number and type of vials used, and assessment of environmental impact (carbon footprint and waste management), Average examination time per protocol, including injection/acquisition time and number of repetitions required to obtain exploitable results

Source: https://euclinicaltrials.eu/ctis-public/view/2025-524884-18-01